EU clinical trial 2024-516266-11-00: Prospective multicenter randomized double-blind study comparing caspofungin to placebo for the treatment of ICU yeast intra-abdominal infection
Protocol code: PI2018_843_0007
Sponsor: Centre Hospitalier Universitaire Amiens Picardie (Hospital/Clinic/Other health care facility). Phase: Therapeutic confirmatory (Phase III). Countries: France (ongoing, recruiting).
Therapeutic area(s): Diseases [C] - Bacterial Infections and Mycoses [C01]
Gender: Female, Male. Age: 18-64 years, 65+ years. Enrolment: 448.
Status: Ongoing, recruiting. Start date (EU): 2020-01-06. Decision date: 2024-08-13. Results received: No. Last updated: 2025-12-02.

Condition(s): yeast intra-abdominal infection, peritonitis
Product: Sodium Chloride B Braun 0,9% süstelahus, CANCIDAS 50 mg powder for concentrate for solution for infusion, CANCIDAS 70 mg powder for concentrate for solution for infusion

Primary endpoint: 28-day failure rate after the beginning of treatment
Endpoint(s): 28 and 90-day mortality, Success rate at the end of treatment, Slope of ß-D-glucan concentrations, 28-day mortality for subgroup analysis

Source: https://euclinicaltrials.eu/ctis-public/view/2024-516266-11-00